EU clinical trial 2024-518095-31-00: Double-blind randomized controlled study versus placebo to evaluate the efficacy of mono-administration of betamethasone in children with symptomatic Adenovirus infection (ADENO-beta)
Sponsor: Azienda Ospedaliera Universitaria Citta Della Salute E Della Scienza Di Torino (Hospital/Clinic/Other health care facility). Phase: Therapeutic confirmatory (Phase III). Countries: Italy (authorised, recruitment pending).
Therapeutic area(s): Diseases [C] - Respiratory Tract Diseases [C08]; Diseases [C] - Virus Diseases [C02]
Gender: Female, Male. Age: 0-17 years. Enrolment: 80.
Status: Authorised, recruitment pending. Decision date: 2024-10-11. Results received: No. Last updated: 2024-10-11.

Condition(s): Adenovirus infection
Product: BENTELAN 0,5 mg compresse effervescenti, Aqua ad iniectabilia Braun, Lösungsmittel zur Herstellung von Parenteralia

Primary endpoint: The primary outcome is the proportion of patients with persistent resolution of fever or proportion of patients who have a body temperature 18 and 24 hours after randomization (TC) <37.5°C
Endpoint(s): Level of pharyngo-tonsillar pain of the child measured via the FLACC scale between 6 months and 35 months, using the Faces Pain Rating Scale (Wong-Baker Scale) between 36 months and 6 months years., Proportion of children requiring hospitalization., Length of hospitalization (among hospitalized patients), measured in days., Cumulative incidence of resolution of fever, calculated from randomization until first body temperature (CT) measurement <37.5°C confirmed by measurement at the next timepoint. − Duration of fever, measured from randomization until the last CT measurement >37.5°.

Source: https://euclinicaltrials.eu/ctis-public/view/2024-518095-31-00